EU clinical trial 2024-512377-27-00: Intradermal LPS to study vascular responses
Sponsor: Centre for Human Drug Research (Laboratory/Research/Testing facility). Phase: Human Pharmacology (Phase I)- Other. Countries: Netherlands (ended).
Therapeutic area(s): Analytical, Diagnostic and Therapeutic Techniques and Equipment [E] - Investigative Techniques [E05]
Gender: Female, Male. Age: 18-64 years. Enrolment: 32.
Status: Ended. Start date (EU): 2024-05-28. End date (EU): 2025-02-06. Decision date: 2024-05-23. Results received: No. Last updated: 2024-08-30.

Condition(s): Immunological/cardiovascular conditions

Source: https://euclinicaltrials.eu/ctis-public/view/2024-512377-27-00